EU clinical trial 2025-523227-22-00: A Therapeutic Non-Inferiority, Randomized, Observer-blind, Active-comparator, Two-arm, Parallel Group, Multi-center Clinical Trial for Comparing the Efficacy and Tolerability of a Generic Fixed Dose Combination of Brimonidine Tartrate 2 mg/ml + Timolol 5 mg/ml Eye Drops versus Combigan® 2 mg/ml + 5 mg/ml Eye Drops in the Treatment of Intraocular Pressure in Patients with Open Angle Glaucoma or Ocular Hypertension
Protocol code: BECRO/OV/BRIMOTIM
Sponsor: OmniVision GmbH (Pharmaceutical company). Phase: Therapeutic confirmatory (Phase III). Countries: Greece (authorised, recruitment pending).
Therapeutic area(s): Diseases [C] - Eye Diseases [C11]
Gender: Female, Male. Age: 18-64 years, 65+ years. Enrolment: 180.
Status: Authorised, recruitment pending. Decision date: 2026-03-27. Results received: No. Last updated: 2026-03-27.

Condition(s): Ocular Hypertension, Glaucoma
Product: Brimonidine-Timolol, Combigan, 2 mg/ml + 5 mg/ml, krople do oczu, roztwór

Primary endpoint: The primary efficacy endpoint will be the difference between Test and Comparator in mean diurnal IOP change from baseline to week 12 visit after adjusting for baseline measurement (week 0).
Endpoint(s): Difference between Test and Comparator in mean diurnal IOP change from baseline to week 2 visit after adjusting for baseline measurement (week 0)., Difference between Test and Comparator in mean diurnal IOP change from baseline to week 6 visit after adjusting for baseline measurement (week 0)., Frequency of study drugs’ related adverse events.

Source: https://euclinicaltrials.eu/ctis-public/view/2025-523227-22-00